EU clinical trial 2025-523278-18-00: Phase IV, single-center, randomized, crossover clinical trial to validate the use of gadopiclenol versus gadobutrol in the evaluation of magnetic resonance imaging (MRI) diagnosis of perianal fistula associated with Crohn's disease
Protocol code: GadoCrohn
Sponsor: Fundacio Hospital Universitari Vall D’Hebron Institut De Recerca (Laboratory/Research/Testing facility). Phase: Therapeutic use (Phase IV). Countries: Spain (authorised, recruitment pending).
Therapeutic area(s): Analytical, Diagnostic and Therapeutic Techniques and Equipment [E] - Diagnosis [E01]
Gender: Female, Male. Age: 18-64 years, 65+ years. Enrolment: 30.
Status: Authorised, recruitment pending. Decision date: 2025-12-18. Results received: No. Last updated: 2025-12-18.

Condition(s): Perianal fistula associated with Crohn's disease
Product: Elucirem 0.5 mmol/mL solution for injection, Gadovist 1.0 mmol/ml solution for injection in prefilled cartridge

Primary endpoint: The main variable to be analyzed is qualitative in nature and corresponds to the correct, verified detection of the perianal fistula tract in the magnetic resonance imaging study. This will be done by direct observation of the MRI studies generated at Visit 2 and Visit 4 by the investigator team.
Endpoint(s): The secondary variables to be analyzed will enable a more exhaustive study of the use of contrast media in this type of pathology, in order to refine its use. The secondary variables are quantitative in nature and are as follows:, CNR (contrast-to-noise ratio) between different regions of interest in the fistulous tract and adjacent healthy tissue., Enhancement contrast percentage in different regions of interest of the fistulous tract before and after contrast medium administration.

Source: https://euclinicaltrials.eu/ctis-public/view/2025-523278-18-00